EU clinical trial 2024-513391-17-00: A Study to Investigate the Safety and Effectiveness of RO7759065 in Combination with Atezolizumab in Participants with Locally Advanced or Metastatic Cancer
Protocol code: GO45296
Sponsor: Genentech Inc. (Pharmaceutical company). Phase: Human Pharmacology (Phase I)- First administration to humans. Countries: Italy (ended), Spain (ended), France (ended).
Therapeutic area(s): Diseases [C] - Neoplasms [C04]
Gender: Female, Male. Age: 18-64 years, 65+ years. Enrolment: 32.
Status: Ended. Start date (EU): 2025-05-27. End date (EU): 2025-12-08. End date: 2025-12-09. Decision date: 2025-04-28. Results received: No. Last updated: 2025-05-06.
Decision dates by country: FR: 2025-04-29, IT: 2025-04-28, ES: 2025-04-29

Condition(s): Locally Advanced or Metastatic Solid Tumors

Source: https://euclinicaltrials.eu/ctis-public/view/2024-513391-17-00